EU clinical trial 2025-523551-54-00: Arthritis interception with Guselkumab in subclinical psoriatic arthritis patients in clinical transition from skin to joint disease: a randomized clinical trial.
Protocol code: ARREST
Sponsor: Azienda Sanitaria Universitaria Friuli Centrale (Hospital/Clinic/Other health care facility). Phase: Therapeutic use (Phase IV). Countries: Italy (authorised, recruitment pending).
Therapeutic area(s): Diseases [C] - Musculoskeletal Diseases [C05]; Diseases [C] - Skin and Connective Tissue Diseases [C17]
Gender: Female, Male. Age: 18-64 years, 65+ years. Enrolment: 90.
Status: Authorised, recruitment pending. Decision date: 2026-01-14. Results received: No. Last updated: 2026-01-20.

Condition(s): PSORIATIC ARTHRITIS PATIENTS IN CLINICAL TRANSITION
Product: CICLOSPORIN, Guselkumab - solution for injection in pre-filled syringe - 100 mg/mL

Primary endpoint: The percentage of patients with subclinical PsA who achieve resolution of arthralgia (defined as VAS pain ≤ 1/10 and TJC ≤ 1/10) together with the effect of guselkumab on objectively quantified synovio-entheseal inflammation, as co-primary objective endpoint evaluated using the UPsA activity activity Score [Timepoint: Week 24].
Endpoint(s): - The change of the synovio-entheseal inflammation score detected by US at w24 and w52, - The incidence of progression to PsA (defined as CASPAR criteria fulfilment) at w52, - The percentage of patients who achieved clinical resolution of arthralgia (defined as VAS pain ≤ 1/10 and TJC ≤ 1/10) at w52, - The percentage of patients who achieve PASI 100 at w24 and w52, - The change of the Patient Reported Outcomes (e.g. HAQ, BASDAI, DLQI, PsAID)., - Change in total modified Sharp–van der Heijde (mSvH) score from baseline to Week 52, including erosion score and joint space narrowing components.

Source: https://euclinicaltrials.eu/ctis-public/view/2025-523551-54-00